EU clinical trial 2024-511182-10-01: A clinical phase IV trial to examine cellular and humoral immunity against measles and chickenpox in children and adolescents 0-18 years in childhood cancer.
Protocol code: immvzmpr1
Sponsor: Vaestra Goetalandsregionen (Hospital/Clinic/Other health care facility). Phase: Therapeutic use (Phase IV). Countries: Sweden (ongoing, recruiting).
Therapeutic area(s): Diseases [C] - Neoplasms [C04]
Gender: Female, Male. Age: 0-17 years. Enrolment: 160.
Status: Ongoing, recruiting. Start date (EU): 2025-05-22. Decision date: 2024-09-27. Results received: No. Last updated: 2024-09-27.

Condition(s): Pediatric cancer
Product: MEASLES, COMBINATIONS WITH MUMPS AND RUBELLA, LIVE ATTENUATED, VARICELLA, LIVE ATTENUATED

Primary endpoint: Difference in VZ IgG antibody levels before and after revaccination against chickenpox, Difference in measles IgG antibody level before and after revaccination against measles
Endpoint(s): Percentage of patients with immunity against chickenpox and measles before and after treatment measured in IgG, Changes in cellmediated immunity (CMI) against chickenpox and measles before and after revaccination. Comparisons with a healthy control group., Differences in antibody levels and CMI between various diagnostic groups (leukemias, solid tumors), different age groups, low- vs. high-intensity treatment, and pre-immune versus non-immune groups

Source: https://euclinicaltrials.eu/ctis-public/view/2024-511182-10-01